EU clinical trial 2024-516414-38-00: Pharmacokinetic boosting of olaparib to improve exposure, tolerance and cost-effectiveness (PROACTIVE-study)
Sponsor: Stichting Radboud universitair medisch centrum (Hospital/Clinic/Other health care facility). Phase: Phase III and phase IV (Integrated). Countries: Netherlands (ongoing, recruiting).
Therapeutic area(s): Diseases [C] - Neoplasms [C04]
Gender: Female, Male. Age: 18-64 years, 65+ years. Enrolment: 82.
Status: Ongoing, recruiting. Start date (EU): 2024-10-01. Decision date: 2024-10-01. Results received: No. Last updated: 2025-07-24.

Condition(s): Cancer
Product: COBICISTAT, OLAPARIB

Primary endpoint: Part A: AUC0-12h for the regular and boosted olaparib will be determined using noncompartmental analysis for the primary objective. Hereto, multiple PK samples will be collected after one week of each treatment regimen at the following times: pre-dose, ½, 1, 1½, 2, 3, 4, 6, 8 hours after olaparib intake. If possible, additional PK samples will be taken after 10 and 12 hours., Part B: The number of patients who require a dose reduction due to toxicity will be registered.

Source: https://euclinicaltrials.eu/ctis-public/view/2024-516414-38-00